EU clinical trial 2023-505323-31-00: A Multicenter, Open-Label Study to Assess The Pharmacokinetics And Safety of Bimekizumab in Pubertal Children And Adolescents With Moderate to Severe Hidradenitis Suppurativa
Protocol code: HS0006
Sponsor: UCB Biopharma (Pharmaceutical company). Phase: Therapeutic confirmatory (Phase III). Countries: Poland (ongoing, recruitment ended), Germany (ongoing, recruitment ended).
Therapeutic area(s): Diseases [C] - Immune System Diseases [C20]
Gender: Female, Male. Age: 0-17 years. Enrolment: 18.
Status: Ongoing, recruitment ended. Start date (EU): 2025-10-09. Decision date: 2025-07-24. Results received: No. Last updated: 2026-05-06.
Decision dates by country: DE: 2025-08-05, PL: 2025-07-28

Condition(s): Hidradenitis Suppurativa
Product: bimekizumab

Primary endpoint: • Geometric mean plasma bimekizumab concentration at Week 16
Endpoint(s): 1. Exposure-adjusted incidence rate of Treatment- Emergent Adverse Events (TEAEs) over the Initial Treatment Period, 2. Exposure-adjusted incidence rate of Serious TEAEs over the Initial Treatment Period, 3. Exposure-adjusted incidence rate of TEAEs leading to withdrawal from study over the Initial Treatment Period, 4. Exposure-adjusted incidence rate of selected Safety Topics of Interest (including incidence of infections [serious, opportunistic, fungal, and TB], IBD, and injection site reactions) over the Initial Treatment Period, 5. Mean Change from Baseline in Systolic Blood Pressure, Diastolic Blood Pressure, and Pulse over the Initial Treatment Period, 6. Mean Change from Baseline in Biochemistry Laboratory Analyses over the Initial Treatment Period, 7. Mean Change from Baseline in Hematology Laboratory Analyses over the Initial Treatment Period, 8. Incidence rate for Positive, Negative, Missing Plasma Anti-Bimekizumab Antibodies during the Initial Treatment Period

Source: https://euclinicaltrials.eu/ctis-public/view/2023-505323-31-00